EU clinical trial 2024-519505-35-00: Evaluating the roLe of Multiplexed PET Imaging in the detection and staging of hepatocellulaR carcinoma and gAstro-entero-pancreatic tumors: a basket diagnostic performance study
Protocol code: RC24_0563
Sponsor: Centre Hospitalier Universitaire De Nantes (Hospital/Clinic/Other health care facility). Phase: Therapeutic confirmatory (Phase III). Countries: France (ongoing, recruiting).
Therapeutic area(s): Diseases [C] - Neoplasms [C04]
Gender: Female, Male. Age: 18-64 years, 65+ years. Enrolment: 28.
Status: Ongoing, recruiting. Start date (EU): 2026-02-02. Decision date: 2025-08-06. Results received: No. Last updated: 2025-08-06.

Condition(s): hepatocellulaR carcinoma, gastro-entero-pancreatic tumors
Product: GALLIUM (68GA) EDOTREOTIDE, FLUOROCHOLINE (18F), FLUDEOXYGLUCOSE (18F)

Primary endpoint: Safety will be monitored after multiplexed radiopharmaceuticals administration and until 30 minutes after the end of the image acquisition. Adverse reactions (ARs) will be collected during that period of time., Technical feasibility will be qualitatively assessed for each patient by the scientific committee at the time of reconstruction of each multiplex acquisition. An image free from artifacts interfering with visual interpretation will be considered as suitable for diagnostic evaluation., The efficacy of multiplexed PET imaging will be assessed by the number, location and quantitative information of positive lesions using the multiplexed approach compared to lesions detected with each single-tracer PET scan. Two independent experts will evaluate both single- tracer PET scans, and the multiplexed scan in order to quantify and localize each detected lesion. All experts will be blinded to the results of the other imaging technique
Endpoint(s): Visual scale grading of multiplexed image for quality assessment (low, acceptable,, Acceptability will be assessed using an ordinal scale from 1 (very uncomfortable) to 5 (very comfortable) and a one-question survey asking participants to indicate their preference between undergoing two separate single-tracer PET scans or one multiplexed PET scan, Ki and Vd computation on each of dynamic image acquisitions (Exploratory analysis for patients who agreed to have dynamic whole body acquisition), Tumor normalized uptake values (SUV) will be determined on each imaging PET (Exploratory analysis for patients who agreed to have dynamic whole body acquisition)

Source: https://euclinicaltrials.eu/ctis-public/view/2024-519505-35-00